EU clinical trial 2024-518654-16-01: Psilocybin in treatment-resistant depression
Sponsor: LKH Graz II (Health care). Phase: Therapeutic exploratory (Phase II). Countries: Austria (authorised, recruitment pending).
Therapeutic area(s): Psychiatry and Psychology [F] - Mental Disorders [F03]
Gender: Female, Male. Age: 18-64 years, 65+ years. Enrolment: 30.
Status: Authorised, recruitment pending. Decision date: 2025-01-30. Results received: No. Last updated: 2025-01-30.

Condition(s): Treatment-resistant depression

Primary endpoint: Severity of depression as measured with the Beck Depression Inventory II 1 week after a 4 weeks of administration of psilocybin

Source: https://euclinicaltrials.eu/ctis-public/view/2024-518654-16-01